EU clinical trial 2023-507180-19-00: International, multi-center, open-label, treatment extension study in patients with multiple myeloma who are still benefitting from isatuximab-based therapy following completion of a Phase 1, 2, or 3 parental study
Protocol code: LTS17704
Sponsor: Sanofi-Aventis Recherche & Developpement (Pharmaceutical company). Phase: Therapeutic exploratory (Phase II). Countries: Italy (ongoing, recruitment ended), Sweden (ongoing, recruitment ended), Finland (ended), Greece (ongoing, recruitment ended), Spain (ongoing, recruitment ended), Czechia (ongoing, recruitment ended), France (ongoing, recruitment ended).
Therapeutic area(s): Diseases [C] - Neoplasms [C04]
Gender: Female, Male. Age: 18-64 years, 65+ years. Enrolment: 37.
Start date (EU): 2023-04-05. Decision date: 2024-04-15. Results received: No. Last updated: 2026-05-15.
Decision dates by country: ES: 2024-04-16, GR: 2024-04-22, SE: 2024-04-16, FR: 2024-04-17, CZ: 2024-04-16, FI: 2024-04-15, IT: 2024-04-19

Condition(s): Cancer
Product: Revlimid 25 mg hard capsules, DexaGalen® 8 mg injekt Injektionslösung, Revlimid 20 mg hard capsules, Pomalidomide Adalvo 3 mg hard capsules, Imnovid 4 mg hard capsules, Imnovid 1 mg hard capsules, Zelvina 5 mg hard capsules, LIBTAYO 350 mg concentrate for solution for infusion., Imnovid 4 mg hard capsules, DIPHENHYDRAMINE, Revlimid 15 mg hard capsules, MONTELUKAST, JAMP Pomalidomide, PARACETAMOL, Revlimid 20 mg hard capsules, Imnovid 3 mg hard capsules, Imnovid 1 mg hard capsules, Revlimid 25 mg hard capsules, Pomalidomide Adalvo 4 mg hard capsules, JAMP Pomalidomide, Zelvina 20 mg hard capsules, Imnovid 2 mg hard capsules, JAMP Pomalidomide, Zelvina 10 mg hard capsules, Revlimid 10 mg hard capsules, Revlimid 15 mg hard capsules, Dexamethason 4 mg JENAPHARM®, DEXAMETHASONE BASE, Zelvina 25 mg hard capsules, SARCLISA 20mg/mL concentrate for solution for infusion., Isatuximab, Imnovid 2 mg hard capsules, Pomalidomide Adalvo 2 mg hard capsules, Revlimid 5 mg hard capsules, Zelvina 15 mg hard capsules, JAMP Pomalidomide, SARCLISA 20mg/mL concentrate for solution for infusion., Kyprolis 60 mg powder for solution for infusion, Revlimid 10 mg hard capsules, Dexamethason 8 mg JENAPHARM®, Imnovid 3 mg hard capsules, METHYLPREDNISOLONE, Revlimid 5 mg hard capsules, SARCLISA 20mg/mL concentrate for solution for infusion., Pomalidomide Adalvo 1 mg hard capsules

Primary endpoint: Number of participants with treatment-emergent adverse events

Source: https://euclinicaltrials.eu/ctis-public/view/2023-507180-19-00